EU clinical trial 2024-512671-12-00: An open-label Phase II/III randomized trial of BNT113 in combination with pembrolizumab versus pembrolizumab monotherapy as a first line therapy in patients with unresectable recurrent, or metastatic Head and Neck Squamous Cell Carcinoma (HNSCC) which is positive for human papilloma virus 16 (HPV16+) and expresses PD-L1
Protocol code: BNT113-01
Sponsor: BioNTech SE (Pharmaceutical company). Phase: Phase II and Phase III (Integrated). Countries: Sweden (ended), Hungary (ongoing, recruiting), Italy (ongoing, recruiting), France (ongoing, recruiting), Czechia (ongoing, recruiting), Spain (ongoing, recruiting), Portugal (ongoing, recruiting), Poland (ongoing, recruiting), Austria (ongoing, recruiting), Belgium (ongoing, recruiting), Germany (ongoing, recruiting).
Therapeutic area(s): Diseases [C] - Neoplasms [C04]
Gender: Female, Male. Age: 18-64 years, 65+ years. Enrolment: 98.
Start date (EU): 2021-03-05. Decision date: 2024-07-03. Results received: No. Last updated: 2026-03-06.
Decision dates by country: PL: 2024-07-24, PT: 2024-07-08, CZ: 2024-08-19, HU: 2024-07-03, BE: 2024-07-12, DE: 2024-07-08, IT: 2024-07-15, SE: 2024-07-03, AT: 2024-07-09, FR: 2024-07-05, ES: 2024-07-16

Condition(s): Unresectable head and neck squamous cell carcinoma, metastatic head and neck cancer, recurrent head and neck cancer
Product: PEMBROLIZUMAB, BNT113

Primary endpoint: Safety Run-In Phase (Part A): Occurrence of TEAEs assessed according to Common Terminology Criteria for Adverse Events version 5.0 (CTCAE v5.0) including Grade ≥3, serious and fatal treatment-emergent adverse events (TEAEs) by relationship., Randomized phase (Part B): Overall survival (OS) defined as the time from randomization to death from any cause., Randomized phase (Part B): Progression-free survival (PFS) defined as the time from randomization to the first objective tumor progression (per RECIST 1.1 assessed by BICR), or death from any cause, whichever occurs first.
Endpoint(s): Safety run-in phase (Part A): ORR defined as the proportion of patients in whom a CR or PR is observed as best overall response. Duration of response (DoR) defined as the time from first objective response (CR or PR) to first occurrence of objective tumor progression or death from any cause, whichever occurs first. Disease control rate (DCR) defined as the proportion of patients in whom a CR or PR or stable disease (SD) is observed as best overall response., Randomized phase (Part B): Overall response rate (ORR) defined as the proportion of patients in whom a complete response (CR) or partial response (PR) (per RECIST 1.1 assessed by BICR) is observed as best overall response., Randomized phase (Part B): Progression-free survival (PFS) defined as the time from randomization to the first objective tumor progression (per RECIST 1.1 by investigator’s assessment), or death from any cause, whichever occurs first., Randomized Phase (Part B): Objective response rate (ORR) defined as the proportion of patients in whom a complete response (CR) or partial response (PR) (per RECIST 1.1 by investigator’s assessment) is observed as best overall response., Randomized Phase (Part B): PFS rate at 6 months defined as the proportion of patients without objective tumor progression (per RECIST 1.1 assessed by BICR) or death from any cause from randomization until 6 months after randomization. PFS rate at 12 months defined as the proportion of patients without objective tumor progression (per RECIST 1.1 assessed by BICR) or death from any cause from randomization until 12 months after randomization., Randomized Phase (Part B): PFS rate at 6 months defined as the proportion of patients without objective tumor progression (per RECIST 1.1 by investigator’s assessment) or death from any cause from randomization until 6 months after randomization. • PFS rate at 12 months defined as the proportion of patients without objective tumor progression (per RECIST 1.1 by investigator’s assessment) or death from any cause from randomization until 12 months after randomization., Randomized Phase (Part B): Duration of Response (DoR) defined as the time from first objective response (CR or PR per RECIST 1.1 assessed by BICR) to first occurrence of objective tumor progression (PD per RECIST 1.1) assessed by BICR), or death from any cause, whichever occurs first., Randomized Phase (Part B): Occurrence of Treatment Emergent Adverse Events (TEAEs) assessed according to CTCAE v5.0 including Grade ≥3, and serious, fatal treatment-emergent adverse events (TEAEs) by relationship. Occurrence of dose reduction, delay, and discontinuation of trial treatments due to TEAEs.

Source: https://euclinicaltrials.eu/ctis-public/view/2024-512671-12-00